EU clinical trial 2025-521621-33-00: Long-term Safety Outcomes in Patients Treated With Replimune Oncolytic Immunotherapy Products
Protocol code: RPL-123-01
Sponsor: Replimune Group Inc. (Pharmaceutical company). Phase: Therapeutic use (Phase IV). Countries: Germany (ongoing, recruiting), Greece (ongoing, recruiting), France (ongoing, recruiting), Poland (ongoing, recruiting), Spain (ongoing, recruiting).
Therapeutic area(s): Diseases [C] - Neoplasms [C04]
Gender: Female, Male. Age: 18-64 years, 65+ years. Enrolment: 41.
Status: Ongoing, recruiting. Start date (EU): 2026-03-16. Decision date: 2026-02-09. Results received: No. Last updated: 2026-07-21.
Decision dates by country: FR: 2026-02-09, GR: 2026-02-11, ES: 2026-02-16, PL: 2026-02-16, DE: 2026-02-11

Condition(s): Melanoma, Hepatocellular Carcinoma, Metastatic Melanoma, Advanced solid tumors
Product: Vusolimogene oderparepvec, RP2, RP3, RP2, Vusolimogene oderparepvec, RP3, RP3, Vusolimogene oderparepvec, RP2, Vusolimogene oderparepvec, Vusolimogene oderparepvec

Primary endpoint: Evaluation of delayed adverse event(s) will be based on the occurrence of: New malignancy(ies); New incidence or exacerbation of a pre-existing neurologic disorder; New incidence or exacerbation of a pre-existing rheumatologic or other autoimmune disorder; New incidence of a hematologic disorder; New incidence of infection related to RPx, New herpetic infection and presence of RPx detected in samples collected from herpetic lesions

Source: https://euclinicaltrials.eu/ctis-public/view/2025-521621-33-00